EU clinical trial 2024-512926-27-00: A randomized phase 3, double-blind, placebo-controlled study of elacestrant plus everolimus versus elacestrant in patients with estrogen receptor-positive/human epidermal growth factor receptor 2-negative, ESR1-mutated, advanced breast cancer progressing to endocrine therapy and CDK4/6 inhibitors - The ADELA study-
Protocol code: MEDOPP545
Sponsor: Medica Scientia Innovation Research S.L., Medica Scientia Innovation Research S.L., Stemline Therapeutics Inc. (Pharmaceutical company). Phase: Therapeutic confirmatory (Phase III). Countries: Austria (authorised, recruitment pending), Czechia (authorised, recruitment pending), Italy (ongoing, recruiting), Greece (authorised, recruitment pending), Spain (ongoing, recruiting), France (authorised, recruitment pending), Germany (authorised, recruitment pending).
Therapeutic area(s): Diseases [C] - Neoplasms [C04]
Gender: Female, Male. Age: 18-64 years, 65+ years. Enrolment: 214.
Start date (EU): 2024-12-12. Decision date: 2024-11-26. Results received: No. Last updated: 2025-02-13.
Decision dates by country: AT: 2024-12-02, ES: 2024-12-02, IT: 2024-11-26, GR: 2024-11-26, DE: 2024-11-27, FR: 2024-11-28, CZ: 2024-11-27

Condition(s): patients with estrogen receptor-positive/human epidermal growth factor receptor 2-negative, ESR1-mutated, advanced breast cancer progressing to endocrine therapy and CDK4/6 inhibitors.
Product: Everolimus-ratiopharm® 2,5 mg Tabletten, GOSERELIN, ORSERDU 86 mg film-coated tablets, ORSERDU 345 mg film-coated tablets, LEUPRORELIN, DEXAMETHASONE, The investigational product is as follows: white tablets, elongated, flat, rounded edges, about 10 mm long and 4 mm wide, with the embossing "EV" on one side and "2.5" on the other side. The list of excipients of Placebo tablet is as follows: Lactose monohydrate, Polyplasdone, Cellulose microcrystalline, Magnesium stearate, Hypromellose., TRIPTORELIN

Primary endpoint: PFS, defined as the period from randomization to the first occurrence of disease progression or death from any cause, whichever occurs first, as assessed by BIRC through the use of RECIST v.1.1.
Endpoint(s): Investigator-assessed PFS, defined as the period from randomization to the first occurrence of disease progression or death from any cause, whichever occurs first, as determined locally through the use of RECIST v.1.1., OS, defined as the period from randomization to death from any cause, as determined locally by the Investigator., ORR, defined as the rate of patients with a best overall response (BOR) of complete response (CR) or partial response (PR), based on a BIRC and local Investigator assessment through the use of RECIST v.1.1., CBR, defined as the rate of patients with an objective response (CR or PR), or stable disease for at least 24 weeks, based on a BIRC and local Investigator assessment through the use of RECIST v.1.1., TTR, defined as the period from randomization to time of the first objective tumor response (tumor shrinkage of ≥ 30%) observed for patients who achieved a BOR of CR or PR, based on a BIRC and local Investigator assessment through the use of RECIST v.1.1., DoR, defined as the period from the first occurrence of a documented objective response to disease progression or death from any cause, whichever occurs first, based on a BIRC and local Investigator assessment through the use of RECIST v.1.1., Best percentage of change from baseline in the size of target tumor lesions, defined as the biggest decrease, or smallest increase if no decrease will be observed, based on a BIRC and local Investigator assessment through the use of RECIST v.1.1., Safety and tolerability, assessed by adverse events (AEs), treatmentemergent adverse events (TEAEs), serious adverse events (SAEs), dose modifications, clinical laboratory parameters (i. e., hematology, chemistry, lipid panel, and coagulation), electrocardiograms (ECGs), performance status, and vital signs., Changes from baseline in EuroQoL 5 Dimension 5 Level (EQ-5D-5L), the European Organization for Research and Treatment of Cancer Quality of Life Questionnaire Core 30 (EORTC QLQ-C30) and the EORTC Breast Cancer-Specific Quality of Life Questionnaire (EORTC QLQ-BR42) scales, and symptoms scores

Source: https://euclinicaltrials.eu/ctis-public/view/2024-512926-27-00